EU clinical trial 2023-504262-32-01: CHemical OptImization of Cerebral Embolectomy in patients with acute stroke treated with mechanical thrombectomy 2 (CHOICE2TRIAL)
Protocol code: CHOICE2
Sponsor: Foundation Clinic For Biomedical Research (Laboratory/Research/Testing facility). Phase: Therapeutic confirmatory (Phase III). Countries: Spain (ended).
Therapeutic area(s): Diseases [C] - Nervous System Diseases [C10]
Gender: Female, Male. Age: 18-64 years, 65+ years. Enrolment: 440.
Status: Ended. Start date (EU): 2023-11-16. End date (EU): 2025-11-13. Decision date: 2023-10-19. Results received: Yes. Last updated: 2025-02-10.

Condition(s): Cerebral Embolectomy in patients with acute stroke
Product: Actilyse, polvo y disolvente para solución inyectable y para perfusión

Primary endpoint: Proportion of patients with a mRS 0 to 1 at 90 days.
Endpoint(s): •Proportion of patients with abnormal microvascular hypoperfusion on CT Perfusion at 36±24h post MT. • Volume of hypoperfusion on brain CTP at 36h±24h post MT •Infarct Expansion Ratio (IER): Final infarct to initial ischemic tissue volumes on brain NCCT at 36±24h post MT. •Barthel Scale score of 95 to 100, at day 90. •Quality of life measured with the EuroQol Group 5-Dimension Self-Report Questionnaire (EQ-5D-5L) at 90 days. •The shift analysis of the modified Rankin Scale (mRS), at day 90.

Source: https://euclinicaltrials.eu/ctis-public/view/2023-504262-32-01